EU clinical trial 2026-526040-13-00: Single-Dose Study in Healthy Participants to Compare the Bioavailability of One Film-Coated Mini-Tablet of Indapamide SR 1.5 mg versus One Film-Coated Tablet of Indapamide IR 2.5 mg Under Fasting Conditions, and to Compare the Bioavailability of One Film-Coated Mini-Tablet of Indapamide SR 1.5 mg Under Fasting versus Fed Conditions.
Protocol code: S005183-303
Sponsor: Institut De Recherches Internationales Servier IRIS (Pharmaceutical company). Phase: Human Pharmacology (Phase I)- Bioequivalence Study. Countries: Portugal (ended).
Therapeutic area(s): Not possible to specify
Gender: Female, Male. Age: 18-64 years. Enrolment: 24.
Status: Ended. Start date (EU): 2026-05-25. End date (EU): 2026-07-24. Decision date: 2026-04-22. Results received: No. Last updated: 2026-05-28.
Decision dates by country: PT: 2026-05-28

Condition(s): No medical condition.

Source: https://euclinicaltrials.eu/ctis-public/view/2026-526040-13-00